EU clinical trial 2023-506610-52-00: A Multicenter, Open-Label Study to Evaluate the Safety, Efficacy, Pharmacokinetics, and Pharmacodynamics of Emicizumab in Patients with Mild or Moderate Hemophilia A without FVIII Inhibitors
Protocol code: BO41423
Sponsor: F. Hoffmann-La Roche AG (Pharmaceutical company). Phase: Therapeutic confirmatory (Phase III). Countries: Germany (ended), France (ended), Belgium (ended).
Therapeutic area(s): Diseases [C] - Hemic and Lymphatic Diseases [C15]
Gender: Female, Male. Age: 0-17 years, 18-64 years, 65+ years. Enrolment: 22.
Status: Ended. Start date (EU): 2020-06-24. End date (EU): 2025-12-08. Decision date: 2024-07-30. Results received: Yes. Last updated: 2025-10-31.
Decision dates by country: FR: 2024-08-01, BE: 2024-07-30, DE: 2024-08-02

Condition(s): Mild or moderate hemophilia A without FVIII inhibitors
Product: Hemlibra 150 mg/mL solution for injection, Hemlibra 30 mg/mL solution for injection

Primary endpoint: 1.Incidence and severity of adverse events, with severity determined according to WHO Toxicity Grading Scale, 2. Incidence of thromboembolic events and thrombotic microangiopathy, 3. Incidence of laboratory abnormalities, injection-site reactions, adverse events leading to drug discontinuation, severe hypersensitivity, anaphylaxis, anaphylactoid events, 4. Change from baseline in physical examination findings, vital signs and ECG parameters, 5. Number of treated bleeds over time
Endpoint(s): 1. Number of all bleeds (i.e., those treated and untreated with FVIII), joint bleeds, target joint bleeds and spontaneous bleeds over time, 2. Joint health, as assessed through use of the Hemophilia Joint Health Score at specified timepoints, 3. Health-related quality of life, as assessed through use of the Comprehensive Assessment Tool of Challenges in Hemophilia Questionnaire over time, 4. Preference for emicizumab compared with previous FVIII regimen, as assessed through use of the Emicizumab Preference Survey, 5. Effect of emicizumab prophylaxis treatment on physical activity compared with physical activity at baseline, 6. Effect of emicizumab prophylaxis treatment on menstruation heaviness and menstruation-related quality of life in female patients, as assessed through the use of the Menstrual Bleeding Questionnaire (MBQ) and the Menstruation Diary (MD) with the Pictorial Blood Assessment Chart (PBAC), 7. Plasma concentration of emicizumab at specified timepoints, 8. Prevalence of anti-drug antibodies (ADAs) at baseline and incidence of ADAs during the study, 9. Number and proportion of patients who develop anti-FVIII inhibitors (titer>= 0.6 BU/mL) at specified timepoints

Source: https://euclinicaltrials.eu/ctis-public/view/2023-506610-52-00